EU clinical trial 2024-512499-36-00: Phase II study of neoadjuvant Dostarlimab in patients with untreated T3-4N0-2 or Stage III pMMR/MSS Resectable Colon Cancer
Sponsor: UZ Leuven (Hospital/Clinic/Other health care facility). Phase: Therapeutic exploratory (Phase II). Countries: Belgium (ongoing, recruiting).
Therapeutic area(s): Diseases [C] - Digestive System Diseases [C06]; Diseases [C] - Neoplasms [C04]
Gender: Female, Male. Age: 18-64 years, 65+ years. Enrolment: 10.
Status: Ongoing, recruiting. Start date (EU): 2025-04-03. Decision date: 2024-12-17. Results received: No. Last updated: 2026-05-28.

Condition(s): pMMR/MSS resectable Colon Cancer
Product: JEMPERLI 500 mg concentrate for solution for infusion

Primary endpoint: Data generation through multi-omic exploration of blood and tissue derived products. Correlation of molecular-biological features identified with pathological response.
Endpoint(s): Safety analysis. Frequency and severity of treatment emergent AEs, SAEs, irAEs. AEs leading to death, discontinuation of trial intervention or resulting in the participant not being suitable for surgery., Proportion of participants with pathological response, determined by local assessment., Survival time defined from Superhero ICF signature to death from any cause. Proportion of survivors at 2 years., Event free survival time (EFS) defined from Superhero ICF signature to recurrence evaluated by local assessment or death.

Source: https://euclinicaltrials.eu/ctis-public/view/2024-512499-36-00